EU clinical trial 2023-509001-76-00: A randomized, double-blind, parallel group, multi-center study to evaluate the long-term safety of salbutamol rescue medication when administered via metered dose inhalers containing the propellant HFA-152a or reference HFA-134a.
Protocol code: 220735
Sponsor: Glaxosmithkline Research & Development Limited (Pharmaceutical company). Phase: Therapeutic confirmatory (Phase III). Countries: Spain (ended), France (ended), Greece (ended), Italy (ended), Poland (ended).
Therapeutic area(s): Diseases [C] - Respiratory Tract Diseases [C08]
Gender: Female, Male. Age: 18-64 years. Enrolment: 227.
Status: Ended. Start date (EU): 2024-07-01. End date (EU): 2025-08-26. End date: 2025-09-02. Decision date: 2024-06-10. Results received: Yes. Last updated: 2025-09-01.
Decision dates by country: IT: 2024-06-11, FR: 2024-06-12, GR: 2024-06-17, PL: 2024-06-14, ES: 2024-06-10

Condition(s): Asthma
Product: Ventolin 100 microgramos/inhalación suspensión para inhalación en envase a presión* (*) sin CFC

Primary endpoint: Incidence of AEs throughout the 3 months treatment period
Endpoint(s): Incidence of SAEs, Minimum serum potassium, Absolute values for serum potassium at each assessed visit, Change from baseline for serum potassium at each assessed visit., Absolute values for clinical laboratory assessments at each assessed visit., Change from baseline for clinical laboratory assessments at each assessed visit, Absolute values for vital signs parameters (systolic blood pressure, diastolic blood pressure, pulse rate) at each assessed visit, Change from baseline for vital signs parameters (systolic blood pressure, diastolic blood pressure, pulse rate) at each assessed visit., Absolute values for 12 Lead ECGs in QTc and heart rate at each assessed visit, Change from baseline for 12 Lead ECGs in QTc and heart rate at each assessed visit., Change from baseline for ACQ-6 score at each assessed visit., Change from baseline for pre-bronchodilator FEV1 at each assessed visit

Source: https://euclinicaltrials.eu/ctis-public/view/2023-509001-76-00